EU clinical trial 2024-512580-31-00: Long-Term Follow-Up of Patients Who Have Received An Autologous Antigen-Specific Chimeric Antigen Receptor T Regulatory Cell Therapy (CAR-Treg therapy, TX200-TR101) In A Prior Clinical study
Protocol code: TX200-KT03
Sponsor: Sangamo Therapeutics Inc. (Pharmaceutical company). Phase: Therapeutic confirmatory (Phase III). Countries: Belgium (ongoing, recruitment ended), Netherlands (ongoing, recruitment ended).
Therapeutic area(s): Phenomena and Processes [G] - Immune system processes [G12]
Gender: Female, Male. Age: 18-64 years, 65+ years. Enrolment: 20.
Status: Ongoing, recruitment ended. Start date (EU): 2023-07-21. Decision date: 2024-07-31. Results received: No. Last updated: 2026-03-02.
Decision dates by country: BE: 2024-07-31, NL: 2024-08-02

Condition(s): Kidney Transplant Rejection
Product: TX200-TR101

Primary endpoint: Overall survival, Indicence and grade of Serious Adverse Events
Endpoint(s): Incidence of immune-mediated rejection in terms of BCAR episodes according to the Banff criteria (including type, severity and timing), Incidence of graft loss due to rejection, Incidence and severity of chronic graft dysfunction, as measured by eGFR

Source: https://euclinicaltrials.eu/ctis-public/view/2024-512580-31-00